EU clinical trial 2024-513145-36-00: Intracochlear Triamcinolone acetonide in sudden sensorineural hearing loss patients - a prospective observer blinded randomized study
Sponsor: Medical University Of Vienna (Educational Institution). Phase: Therapeutic exploratory (Phase II). Countries: Austria (ongoing, recruiting).
Therapeutic area(s): Diseases [C] - Otorhinolaryngologic Diseases [C09]
Gender: Female, Male. Age: 18-64 years, 65+ years. Enrolment: 40.
Status: Ongoing, recruiting. Start date (EU): 2024-12-11. Decision date: 2024-12-11. Results received: No. Last updated: 2024-12-11.

Condition(s): Sudden sensori neural hearing loss
Product: Volon® A 40 mg-Kristallsuspension-Spritzampulle

Primary endpoint: Mean hearing threshold shift on day 30 postoperatively in three sequential frequencies most affected by SSHL.
Endpoint(s): Freiburger monosyllable speech intelligibility test and the oldenburg sentence test on day 30 postoperatively, Intensity of tinnitus, quality of speech intelligibility and the perception of the own health condition on day 30 postoperatively, Proteomics of the perilymph, Concentration of triamcinolone acetonide (if applicable) and proteins depending on the results of the perilymph proteomics

Source: https://euclinicaltrials.eu/ctis-public/view/2024-513145-36-00